EU clinical trial 2024-512107-39-00: Continuous Wound Infiltration versus placebo following elective minimally invasive colorectal surgery; a double-blinded, randomised, placebo-controlled, low-intervention trial (CIMICS trial)
Protocol code: 2024-512107-39
Sponsor: Catharina Ziekenhuis Stichting (Hospital/Clinic/Other health care facility). Phase: Therapeutic confirmatory (Phase III). Countries: Netherlands (ongoing, recruiting).
Therapeutic area(s): Diseases [C] - Digestive System Diseases [C06]
Gender: Female, Male. Age: 18-64 years, 65+ years. Enrolment: 192.
Status: Ongoing, recruiting. Start date (EU): 2024-10-30. Decision date: 2024-07-11. Results received: No. Last updated: 2024-07-11.

Condition(s): Recovery following elective minimally invasive colorectal surgery, Recovery following elective minimally invasive colorectal surgery
Product: Bupivacaïne Eugia 2,5 mg/ml, oplossing voor injectie, Natriumchloride Noridem 0,9%, oplossing voor injectie en oplosmiddel voor parenteraal gebruik 9 mg/ml

Primary endpoint: Postoperative recovery will be measured and recorded using the Quality of Recovery (QoR) Questionnaire score, conducted daily from the first postoperative day until the fifth postoperative day (see addendum A). The questionnaire will be prompted and completed digitally using the electronic case report form (eCRF) of an ISO 27001 certified study database.
Endpoint(s): Postoperative pain levels will be measured and recorded using the Numeric Rating Scale (NRS), contained within the daily questionnaire (see addendum A). The questionnaire will be prompted and completed digitally using the electronic case report form (eCRF) of an ISO 27001 certified study database. Additionally, NRS score will be registered daily by nursing staff during postoperative hospital stay, as is standard in the participating centre., Postoperative analgesic use will be recorded within the daily questionnaire (see addendum A). The questionnaire will be prompted and completed digitally using the electronic case report form (eCRF) of an ISO 27001 certified study database. Additionally, administration of any medication (including administration of opioids) will be registered by the treating physician, as is standard in the participating centre. Opioid consumption will be converted to milligrams (mg) of morphine equivalents., Date of discharge and functional recovery will be noted in the patient file by the treating physician., Possible complications will be included from date of surgery up to 90 days after surgery and are registered in the patient file by the treating physician. Complications will be graded according to Clavien-Dindo. These data will be extracted from de EIAS database as well as the patient file., These markers of recovery will be noted by the nursing staff in the patient file, as is standard in the participating centre, and will additionally be included in the daily questionnaire., ERAS compliance data will be extracted from the EIAS database, where it is noted in percentage of adhered pre-, intra-, and post-operative guidelines.

Source: https://euclinicaltrials.eu/ctis-public/view/2024-512107-39-00